EU clinical trial 2023-504951-29-00: A Multicenter, Randomized, Double-Blind, Placebo Controlled Maintenance and Long-Term Extension Study of the Efficacy and Safety of Upadacitinib (ABT-494) in Subjects with Crohn's Disease Who Completed the Studies M14-431 or M14-433
Protocol code: M14-430
Sponsor: AbbVie Deutschland GmbH & Co. KG (Pharmaceutical company). Phase: Therapeutic confirmatory (Phase III). Countries: Denmark (ongoing, recruitment ended), Germany (ongoing, recruitment ended), Greece (ongoing, recruitment ended), Portugal (ongoing, recruitment ended), Spain (ongoing, recruitment ended), Netherlands (ongoing, recruitment ended), Sweden (ended), Latvia (ongoing, recruitment ended), Romania (ongoing, recruitment ended), Czechia (ongoing, recruitment ended), Croatia (ongoing, recruitment ended), Slovakia (ongoing, recruitment ended), Hungary (ongoing, recruitment ended), Belgium (ongoing, recruitment ended), Austria (ended), France (ended), Lithuania (ongoing, recruitment ended), Italy (ongoing, recruitment ended), Poland (ongoing, recruitment ended).
Therapeutic area(s): Diseases [C] - Digestive System Diseases [C06]
Gender: Female, Male. Age: 18-64 years, 65+ years. Enrolment: 230.
Start date (EU): 2017-07-27. Decision date: 2023-10-24. Results received: No. Last updated: 2026-06-23.
Decision dates by country: FR: 2023-11-10, SE: 2023-10-25, BE: 2023-10-25, NL: 2023-10-25, SK: 2023-10-25, LV: 2023-10-24, DK: 2023-10-25, PL: 2023-12-06, HU: 2023-10-25, LT: 2023-11-10, GR: 2023-10-30, PT: 2023-10-26, RO: 2023-10-25, ES: 2023-10-30, AT: 2023-10-30, IT: 2023-11-13, DE: 2023-10-30, HR: 2023-10-27, CZ: 2023-10-25

Condition(s): Crohn's Disease
Product: Upadacitinib, Upadacitinib, Matching Placebo identical to IMP

Primary endpoint: Sub-study 1 Cohort 1 (Upadacitinib vs Placebo): Proportion of subjects with clinical remission per PROs at Week 52, Sub-study 1 Cohort 1 (Upadacitinib vs Placebo): Proportion of subjects with endoscopic response at Week 52, Sub-study 2: Occurrence rate of subjects with total hospitalizations (all-cause) over time with CD-related hospitalizations over time with surgeries over time with CD-related surgeries over time
Endpoint(s): Sub-study 1: Proportion of subjects with clinical remission per CDAI at Week 52, Sub-study 1: Proportion of subjects with endoscopic remission at Week 52, Sub-study 1: Change from Baseline in IBDQ at Week 52, Sub-study 1: Proportion of subjects achieving CR-100 at Week 52, Sub-study 1: Proportion of subjects without corticosteroid use for CD at least 90 days prior to Week 52 and achieved clinical remission per PROs at Week 52 (among all subjects), Sub-study 1: Proportion of subjects who discontinued corticosteroid use for CD at least 90 days prior to Week 52 and achieved clinical remission per PROs at Week 52 in subjects taking corticosteroids for CD at Baseline of induction, Sub-study 1: Proportion of subjects with clinical remission per PROs at Week 0 and Week 52, Sub-study 1: Change from Baseline in FACIT-F at Week 52, Sub-study 1: Proportion of subjects with clinical remission per PROs and endoscopic remission at Week 52, Sub-study 1: Proportion of subjects with CD-related hospitalizations during the 52 Week double-blind maintenance period, Sub-study 1: Proportion of subjects with resolution of EIMs at Week 52, in subjects with EIMs at Baseline, Sub-study 2: Proportion of subjects with clinical remission over time, Sub-study 2: Proportion of subjects with enhanced clinical response over time, Sub-study 2: Proportion of subjects with clinical response over time, Sub-study 2: Proportion of subjects with CR-100 over time, Sub-study 2: Proportion of subjects with endoscopic remission at Week 0, and every 48 weeks thereafter, Sub-study 2: Proportion of subjects with endoscopic response at Week 0, and every 48 weeks thereafter, Sub-study 2: Proportion of subjects without corticosteroid use for CD for at least 90 days and achieve clinical remission over time, Sub-study 2: Time to loss of enhanced clinical response, Sub-study 2: Time to loss of clinical remission

Source: https://euclinicaltrials.eu/ctis-public/view/2023-504951-29-00